EU clinical trial 2022-502174-16-00: (22153) Randomized, Double-Masked, Active-Controlled, Phase 3 Study of the Efficacy and Safety of Aflibercept 8 mg in Macular Edema Secondary to Retinal Vein Occlusion
Protocol code: 22153
Sponsor: Bayer AG (Pharmaceutical company). Phase: Therapeutic confirmatory (Phase III). Countries: France (ended), Slovakia (ended), Portugal (ended), Lithuania (ended), Hungary (ended), Spain (ended), Italy (ended), Czechia (ended), Austria (ended), Latvia (ended), Estonia (ended), Bulgaria (ended), Poland (ended), Germany (ended).
Therapeutic area(s): Diseases [C] - Eye Diseases [C11]
Gender: Female, Male. Age: 18-64 years, 65+ years. Enrolment: 255.
Status: Ended. Start date (EU): 2023-09-13. End date (EU): 2025-05-14. End date: 2025-05-27. Decision date: 2023-08-22. Results received: Yes. Last updated: 2025-06-02.
Decision dates by country: SK: 2023-08-22, CZ: 2023-08-24, IT: 2023-08-24, LV: 2023-08-28, LT: 2023-08-23, EE: 2023-08-28, ES: 2023-08-28, FR: 2023-08-23, PL: 2023-08-28, DE: 2023-11-27, BG: 2023-08-28, HU: 2023-08-28, PT: 2023-08-23, AT: 2023-08-28

Condition(s): Macular edema secondary to retinal vein occlusion
Product: Eylea 40 mg/mL solution for injection in a vial, AFLIBERCEPT, FLUORESCEIN, Eylea

Primary endpoint: Change from baseline in BCVA measured by the ETDRS letter score at Week 36
Endpoint(s): Number of active injections from baseline to Week 64, Number of active injections from baseline to Week 36, Change from baseline in BCVA measured by the Early Treatment Diabetic Retinopathy Study (ETDRS) letter score at Week 44, Change from baseline in BCVA measured by the ETDRS letter score at Week 64, Participant gaining at least 15 letters in BCVA from baseline at Weeks 36 and 64, Participant achieving an ETDRS letter score of at least 69 (approximate 20/40 Snellen equivalent) at Weeks 36 and 64, Participant having no intraretinal fluid (IRF) and no sub-retinal fluid (SRF) in the center subfield at Weeks 36 and 64, Change from baseline in CST at Weeks 36 and 64, Change from baseline in National Eye Institute Visual Functioning Questionnaire-25 (NEI-VFQ-25) total score at Weeks 36 and 64, Occurrence of treatment-emergent adverse events (TEAEs) and serious adverse events (SAEs) through Weeks 36 and 64, Participant dosed only Q8W through Week 36 in the 8 mg Q8W group, Participant having last treatment interval ≥12 or of 16 weeks at Week 64, Participant having next intended interval ≥12, ≥16 or of 20 weeks at Week 64, Systemic exposure to aflibercept as assessed by plasma concentrations of free, adjusted bound and total aflibercept from baseline through Weeks 36 and 64

Source: https://euclinicaltrials.eu/ctis-public/view/2022-502174-16-00